EU clinical trial 2025-522125-36-00: A study to determine the safety and effect of antibodies against hepatitis D (the SAMBA-D study)
Protocol code: SAMBA-D-001
Sponsor: Region Midtjylland (Hospital/Clinic/Other health care facility). Phase: Human Pharmacology (Phase I)- Other. Countries: Germany (authorised, recruitment pending), Denmark (ongoing, recruiting).
Therapeutic area(s): Diseases [C] - Virus Diseases [C02]
Gender: Female, Male. Age: 18-64 years, 65+ years. Enrolment: 15.
Start date (EU): 2026-04-22. Decision date: 2026-01-19. Results received: No. Last updated: 2026-07-30.
Decision dates by country: DE: 2026-01-19, DK: 2026-01-19

Condition(s): Chronic hepatitis D infection

Source: https://euclinicaltrials.eu/ctis-public/view/2025-522125-36-00